EU clinical trial 2023-503666-23-00: A Randomized, Partially Masked, Controlled, Phase 3 Clinical Study to Evaluate the Efficacy and Safety of RGX-314 Gene Therapy in Participants with nAMD (ASCENT)
Protocol code: RGX-314-3101/M23-409
Sponsor: Abbvie Deutschland GmbH & Co. KG (Pharmaceutical company). Phase: Therapeutic confirmatory (Phase III). Countries: Germany (ongoing, recruitment ended), Italy (ongoing, recruitment ended), France (ongoing, recruitment ended), Hungary (ongoing, recruitment ended), Spain (ongoing, recruitment ended).
Therapeutic area(s): Diseases [C] - Eye Diseases [C11]
Gender: Female, Male. Age: 18-64 years, 65+ years. Enrolment: 88.
Status: Ongoing, recruitment ended. Start date (EU): 2024-06-07. Decision date: 2024-02-15. Results received: No. Last updated: 2026-06-04.
Decision dates by country: ES: 2024-03-05, IT: 2024-02-20, HU: 2024-02-19, DE: 2024-02-20, FR: 2024-04-17

Condition(s): Neovascular age-related macular degeneration
Product: Surabgene Lomparvovec (ABBV-RGX-314), Lucentis 10 mg/ml solution for injection in pre-filled syringe, Eylea 40 mg/mL solution for injection in pre-filled syringe, Surabgene Lomparvovec (ABBV-RGX-314)

Primary endpoint: Mean change from baseline in BCVA to Week 54 based on the ETDRS score (noninferiority to the active control).
Endpoint(s): 1. Incidences of ocular and overall AEs over 54 weeks, 2. Proportion of participants with BCVA of 40 letters (20/160 approximate Snellen equivalent) or worse at Week 54, 3. Proportion of participants with BCVA of 84 letters (20/20 approximate Snellen equivalent) or better at Week 54, 4. Proportion of participants (1) gaining ≥ 15, ≥ 10, ≥ 5, or ≥ 0 letters; (2) losing ≥ 15, ≥ 10, ≥ 5, or > 0 letters; (3) maintaining vision (not losing ≥ 15 letters) compared with Baseline as per BCVA at Week 54, 5. Mean change from Baseline in BCVA to Week 54 for participants who received ≤ 3 supplemental anti-VEGF injections, ≤ 2 supplemental anti-VEGF injections, ≤ 1 supplemental anti-VEGF injection, or 0 supplemental anti-VEGF injections (ABBV RGX 314 randomized participants), 6. Mean change from Week 54 to Week 108 in BCVA (control arm participants who cross over to ABBV-RGX-314), 7. Mean change from Baseline in CRT as measured by SD-OCT to Week 54, 8. Mean change from Week 54 to Week 108 in CRT, as measured by SD-OCT (control arm participants who cross over to ABBV-RGX-314), 9. Mean change from Baseline in CPT as measured by SD-OCT to Week 54, 10. Mean change from Week 54 to Week 108 in CPT, as measured by SD-OCT (control arm participants who cross over to ABBV RGX 314), 11. Mean number of supplemental anti-VEGF injections from Baseline through Week 54 (ABBV-RGX-314 randomized participants) and from Week 54 through Week 108 (control arm participants who cross over to ABBV-RGX-314), 12. Proportion of participants with 0, 1, 2, and 3 supplemental injections through Week 54 (ABBV-RGX-314 randomized participants) and from Week 54 through Week 108 (control arm participants who cross over to ABBV-RGX-314), 13. Proportion of participants with ≤ 1, ≤ 2, and ≤ 3 supplemental injections through Week 54 (ABBV-RGX-314 randomized participants) and from Week 54 through Week 108 (control arm participants who cross over to ABBV-RGX-314), 14. In the subset of participants who were given supplemental anti-VEGF injections, proportion of participants that received 1 or 2 injections through Week 54 (ABBV-RGX-314 randomized participants) and from Week 54 through Week 108 (control arm participants who cross over to ABBV-RGX-314), 15. Proportion of participants with a reduction of ≥ 50% in anti-VEGF injection annualized rate through Week 54 compared with the prior year (ABBV-RGX-314 randomized participants), 16. Proportion of participants with a reduction of ≥ 75% in anti-VEGF injection annualized rate through Week 54 compared with the prior year (ABBV-RGX-314 randomized participants), 17. Percent reduction in anti-VEGF injection annualized rate through Week 54 compared with the prior year (ABBV-RGX-314 randomized participants), 18. Supplemental anti-VEGF injection annualized rate through Week 54 (ABBV-RGX-314 randomized participants), 19. Percent reduction in anti-VEGF injection annualized rate after Week 58 through Week 108 relative to the year prior to the study (control arm participants who cross over to ABBV-RGX-314), 20. Supplemental anti-VEGF injection annualized rate after Week 58 through Week 108 (control arm participants who cross over to ABBV-RGX-314), 21. Time to first supplemental anti-VEGF injection after the Week 2 injection (ABBV-RGX-314 randomized participants), 22. Time to first supplemental anti-VEGF injection after the Week 58 injection (control arm participants who cross over to ABBV RGX 314)

Source: https://euclinicaltrials.eu/ctis-public/view/2023-503666-23-00